EU clinical trial 2024-516480-90-00: A Randomized, Double-blind Study to Evaluate the Efficacy and Safety of Cabozantinib (XL184) at 60 mg/Day Compared to 140 mg/Day in Progressive, Metastatic Medullary Thyroid Cancer Patients
Protocol code: XL184-401
Sponsor: Exelixis Inc. (Pharmaceutical company). Phase: Therapeutic use (Phase IV). Countries: Hungary (ongoing, recruitment ended), Poland (ongoing, recruitment ended), Romania (ongoing, recruitment ended), Croatia (ongoing, recruitment ended).
Therapeutic area(s): Diseases [C] - Neoplasms [C04]
Gender: Female, Male. Age: 18-64 years, 65+ years. Enrolment: 10.
Status: Ongoing, recruitment ended. Start date (EU): 2015-11-23. Decision date: 2024-12-04. Results received: No. Last updated: 2025-12-17.
Decision dates by country: HU: 2024-12-04, PL: 2024-12-09, HR: 2024-12-09, RO: 2024-12-06

Condition(s): Metastatic Medullary Thyroid Cancer
Product: COMETRIQ 20 mg + 80 mg hard capsules, PL2, film-coated tablets, oral use, CABOMETYX 20 mg film-coated tablets, PL4, capsule, hard, oral use, PL1, film-coated tablets, oral use, COMETRIQ 20 mg + 80 mg hard capsules, COMETRIQ 20 mg hard capsules, CABOMETYX 60 mg film-coated tablets, COMETRIQ 20 mg + 80 mg hard capsules, PL3, capsule, hard, oral use, COMETRIQ 20 mg hard capsules, COMETRIQ 20 mg + 80 mg hard capsules

Primary endpoint: Progression free survival (PFS) per RECIST 1.1 per independent radiology review
Endpoint(s): Objective response rate (ORR) per RECIST 1.1 per independent radiology review

Source: https://euclinicaltrials.eu/ctis-public/view/2024-516480-90-00